EU clinical trial 2024-513553-79-00: Efficacy and tolerability of ODM-111 in chronic pain due to osteoarthritis of the knee
Protocol code: 3133003
Sponsor: Orion Corporation (Pharmaceutical company). Phase: Therapeutic exploratory (Phase II). Countries: Czechia (ended), Poland (ended), Spain (ended), Germany (ended), Denmark (ended).
Therapeutic area(s): Diseases [C] - Musculoskeletal Diseases [C05]
Gender: Female, Male. Age: 18-64 years, 65+ years. Enrolment: 234.
Status: Ended. End date (EU): 2024-10-28. Decision date: 2024-10-16. Results received: Yes. Last updated: 2024-10-28.
Decision dates by country: CZ: 2024-10-23, DK: 2024-10-21, DE: 2024-10-16, ES: 2024-10-22, PL: 2024-10-28

Condition(s): Chronic Pain due to Ostheoarthritis of the knee
Product: ODM-111 Placebo, Para-Tabs 500 mg tabletti, ODM-111, ODM-111

Primary endpoint: The primary efficacy endpoint is the change from baseline to week 6 in the Western Ontario and McMaster Universities Osteoarthritis Index (WOMAC) pain subscale

Source: https://euclinicaltrials.eu/ctis-public/view/2024-513553-79-00